EU clinical trial 2024-516180-85-00: An open-label, randomised, phase III study comparing trifluridine/tipiracil (S 95005) in combination with bevacizumab to capecitabine in combination with bevacizumab in first-line treatment of patients with metastatic colorectal cancer who are not candidate for intensive therapy (SOLSTICE study).
Protocol code: CL3-95005-006
Sponsor: Institut De Recherches Internationales Servier IRIS (Pharmaceutical company). Phase: Therapeutic confirmatory (Phase III). Countries: Sweden (ended), Slovakia (ongoing, recruitment ended), Poland (ongoing, recruitment ended), Denmark (ended).
Therapeutic area(s): Diseases [C] - Neoplasms [C04]
Gender: Female, Male. Age: 18-64 years, 65+ years. Enrolment: 84.
Start date (EU): 2019-04-15. Decision date: 2024-10-15. Results received: No. Last updated: 2025-09-29.
Decision dates by country: SE: 2024-10-16, SK: 2024-10-15, DK: 2024-10-15, PL: 2024-11-08

Condition(s): Metastatic colorectal cancer
Product: Avastin 25 mg/ml concentrate for solution for infusion., Lonsurf 20 mg/8.19 mg film-coated tablets, Lonsurf 15 mg/6.14 mg film-coated tablets, Lonsurf 20 mg/8.19 mg film-coated tablets, Xeloda 150 mg film-coated tablets, Xeloda 500 mg film-coated tablets, Avastin 25 mg/ml concentrate for solution for infusion.

Primary endpoint: Progression-free survival (PFS) based on investigator judgement
Endpoint(s): Overall survival (OS), Overall response rate (ORR), Disease control rate (DCR), Duration of response (DoR), Time to treatment failure (TTF), Safety and tolerability assessed by incidence of adverse events (AE), laboratory tests, physical examination and performance status (ECOG), vital signs, 12-leads ECG parameters, Quality of life (QoL)

Source: https://euclinicaltrials.eu/ctis-public/view/2024-516180-85-00